EU clinical trial 2022-500646-14-00: Immunotherapy in patients with early dMMR rectal cancer. A Danish DCCG phase II trial
Sponsor: Odense University Hospital (Hospital/Clinic/Other health care facility). Phase: Therapeutic exploratory (Phase II). Countries: Denmark (ongoing, recruiting).
Therapeutic area(s): Diseases [C] - Neoplasms [C04]
Gender: Female, Male. Age: 18-64 years, 65+ years. Enrolment: 39.
Status: Ongoing, recruiting. Start date (EU): 2023-01-31. Decision date: 2022-07-04. Results received: No. Last updated: 2026-06-26.

Condition(s): cancer
Product: OPDIVO 10 mg/mL concentrate for solution for infusion., YERVOY 5 mg/ml concentrate for solution for infusion

Primary endpoint: Number of patients with clinical complete response evaluated day 93 (+/- 7 days) after one or two cycles of immunotherapy. Complete clinical response will be defined as no visible or palpable tumor examined by rectal exploration (if low tumors), endoscopy and MR-scan. Patients with definite but less than complete regression BUT with a representative biopsy without viable tumor cells will also be classified as cCR in this trial.
Endpoint(s): Number of patients with biological complete response after 1 or 2 cycles of immunotherapy., Number of patients without any sign of recurrence after 12 months., Response rate according to mrTRG (24)., Adverse events., Correlation between bio-markers (ctDNA and CEA) and outcome., Quality of life (EORCT QLQ-C30 and EORCT QLQ-CR29)., Survival follow up data

Source: https://euclinicaltrials.eu/ctis-public/view/2022-500646-14-00